EU clinical trial 2022-500257-16-00: A Phase 3, Multicenter, Randomized, Double-Blind Study to Evaluate the Safety and Efficacy of Contezolid Acefosamil and Contezolid Compared to Linezolid Administered Intravenously and Orally to Adults with Moderate or Severe Diabetic Foot Infections
Protocol code: MRXC-302
Sponsor: Micurx Pharmaceuticals Inc. (Pharmaceutical company). Phase: Therapeutic confirmatory (Phase III). Countries: Portugal (ended), Lithuania (ended), Latvia (ongoing, recruiting), Spain (ended), Italy (ongoing, recruiting), France (ended), Greece (ended), Estonia (ongoing, recruiting), Hungary (ended), Bulgaria (ongoing, recruiting), Croatia (ended), Poland (ongoing, recruiting), Slovakia (ended), Czechia (ended), Romania (ended).
Therapeutic area(s): Diseases [C] - Bacterial Infections and Mycoses [C01]
Gender: Female, Male. Age: 18-64 years, 65+ years. Enrolment: 644.
Start date (EU): 2023-03-17. Decision date: 2022-11-29. Results received: No. Last updated: 2026-03-09.
Decision dates by country: FR: 2022-11-29, ES: 2022-12-02, PT: 2022-12-02, GR: 2022-11-30, HR: 2023-07-03, CZ: 2025-03-10, RO: 2025-02-24, HU: 2022-11-30, LT: 2022-12-02, SK: 2023-03-10, EE: 2022-12-05, IT: 2022-12-02, LV: 2022-12-02, BG: 2023-03-20, PL: 2023-05-15

Condition(s): Diabetic Foot Infections
Product: Contezolid acefosamil, Linezolid, AZTREONAM, Contezolid, Flagyl 400mg Tablets, AZTREONAM, METRONIDAZOL BRAUN 5 mg/ ml, soluţie perfuzabilă, Linezolid Tablets 600mg, Placebo to match contezolid and Linezoloid tablets

Primary endpoint: 1. The primary objective is to evaluate the Investigator’s assessment of clinical response at the D35 visit in subjects receiving contezolid acefosamil/contezolid compared to subjects receiving linezolid in the MITT analysis set, 2. Evaluate safety and tolerability of contezolid acefosamil (IV)/contezolid (PO) compared with linezolid (IV and PO)
Endpoint(s): 1. Evaluate the Investigator’s assessment of clinical response at End-of-Therapy (EOT) visit in the MITT analysis set, 2. Evaluate the Investigator’s assessment of clinical response at D35 visit in the Clinically Evaluable (CE) at D35 (CE-D35) analysis set, 3. Per-subject microbiological response at D35, 4. Per-pathogen microbiological response at D35, 5. Per-pathogen microbiological response at EOT, 6. Composite endpoint of death, unplanned amputation, and infectious complications of the primary DFI by Day 35, 7. Evaluate early clinical response as equal or greater than 20% percent reduction in the surface area of redness, edema, and/or induration of the primary DFI site at Day 5 (± 1day), compared to Baseline, in patients who did not receive any rescue antibiotic therapy and are alive in the MITT analysis set.

Source: https://euclinicaltrials.eu/ctis-public/view/2022-500257-16-00